EU clinical trial 2025-520929-20-00: MULTICENTER, DOUBLE BLIND CLINICAL TRIAL TO EVALUATE THE ANTIHEMORRAGIC EFFECT OF THE TOPICAL TRANEXAMIC ACID DURING PACEMAKER IN ANTICOAGULATED PATIENTS
Protocol code: HTAJ-TRANEX-2019-01
Sponsor: Hospital Universitario Tajo (Health care). Phase: Therapeutic confirmatory (Phase III). Countries: Spain (authorised, recruitment pending).
Therapeutic area(s): Diseases [C] - Cardiovascular Diseases [C14]
Gender: Female, Male. Age: 18-64 years, 65+ years. Enrolment: 100.
Status: Authorised, recruitment pending. Decision date: 2025-01-30. Results received: No. Last updated: 2025-01-30.

Condition(s): PACEMAKER IN ANTICOAGULATED PATIENTS
Product: Amchafibrin 500 mg solución inyectable

Primary endpoint: Evaluation of hemorrhage and/or hematoma in patients anticoagulated with acenocoumarol after pacemaker implantation and the effect of tranexamic acid (TXA) to reduce these events.
Endpoint(s): Assess the occurrence of the following events: • Infectious complications • Duration of the procedure • Hospital stay • Need for blood products • Need for prohemostatic drugs • Thrombotic complications

Source: https://euclinicaltrials.eu/ctis-public/view/2025-520929-20-00